EU clinical trial 2023-503348-15-00: A Phase 1/2a, Open-label, Dose Escalation Trial of GEN3017 with Expansion Cohorts in Relapsed or Refractory CD30+ Classical Hodgkin Lymphoma and CD30+ Non-Hodgkin Lymphoma
Protocol code: GCT3017-01
Sponsor: Genmab A/S (Pharmaceutical company). Phase: Phase I and Phase II (Integrated)- First administration to humans. Countries: Germany (ended), Denmark (ended), Italy (ended), Netherlands (ended), France (ended).
Therapeutic area(s): Diseases [C] - Hemic and Lymphatic Diseases [C15]; Diseases [C] - Immune System Diseases [C20]
Gender: Female, Male. Age: 18-64 years, 65+ years. Enrolment: 109.
Status: Ended. End date (EU): 2024-11-04. End date: 2025-02-05. Decision date: 2023-11-13. Results received: Yes. Last updated: 2024-12-16.
Decision dates by country: DK: 2023-11-13, FR: 2023-11-20, DE: 2023-11-17, IT: 2023-11-15, NL: 2023-11-20

Condition(s): Hodgkin lymphoma or non-Hodgkin lymphoma
Product: PREDNISOLONE, PARACETAMOL, SILTUXIMAB, ANAKINRA, DIPHENHYDRAMINE, TOCILIZUMAB, DuoBody-CD3xCD30

Primary endpoint: Dose Escalation: Incidence of dose-limiting toxicities (DLTs), Incidence and severity of adverse events (AEs), Expansion: ORR based on the Lugano criteria as assessed by independent review committee (IRC)
Endpoint(s): Dose Escalation: Noncompartmental PK parameters: • Maximum concentration (Cmax) • Time to Cmax (tmax) • Predose trough concentration (Ctrough) • Area under the concentration-time curve from time 0 to last quantifiable sample (AUClast) and from time 0 to infinity (AUCinf) • Elimination half-life (T1/2) • Clearance • Volume of distribution, Dose Escalation: Anti-GEN3017 antibodies, Dose Escalation: Anti-tumor activity based on the Lugano criteria as assessed by investigator: • Objective response rate (ORR) • Duration of response (DOR) • Time to response (TTR), Expansion: Anti-tumor activity based on the Lugano criteria as assessed by IRC and investigator: • ORR (investigator only) • CR (complete response) rate • DOR • TTR • PFS (progression-free survival) • OS (overall survival), Expansion: • Safety: Incidence and severity of AEs and serious adverse events (SAEs) • Immunogenicity: Anti-GEN3017 antibodies, Expansion: PK parameters (clearance; volume of distribution; AUClast; AUCinf; Cmax; Tmax; Ctrough; and t1/2)

Source: https://euclinicaltrials.eu/ctis-public/view/2023-503348-15-00